EU clinical trial 2023-510517-26-00: A SAFETY RUN-IN AND PHASE 2, OPEN-LABEL, MULTICENTRE, STUDY INVESTIGATING SAFETY, TOLERABILITY AND EFFECTIVENESS OF VENETOCLAX ADD IN COMBINATION AT FLUDARABINE, CYRATABINE AND IDARUBICINE IN INDUCTION THERAPY OF NEW ONSET NON-M3 ACUTE MYELOID LEUKEMIA. V-FIRST - AML1718
Protocol code: AML1718
Sponsor: Fondazione Gimema Franco Mandelli Onlus (Patient organisation/association). Phase: Phase I and Phase II (Integrated)- Other. Countries: Italy (ended).
Therapeutic area(s): Diseases [C] - Hemic and Lymphatic Diseases [C15]
Gender: Female, Male. Age: 18-64 years, 65+ years. Enrolment: 124.
Status: Ended. Start date (EU): 2018-10-26. End date (EU): 2025-07-21. Decision date: 2024-08-05. Results received: No. Last updated: 2024-08-05.

Condition(s): Acute Myeloid Leukemia
Product: FLUDARABINE PHOSPHATE, IDARUBICIN, Venclyxto 10 mg film-coated tablets, Venclyxto 100 mg film-coated tablets, CYTARABINE, Venclyxto 50 mg film-coated tablets

Primary endpoint: Primary end point is % of CR (CR + CRi + CRp) after course 1 or course 2 if course 2 is administered
Endpoint(s): Incidence time and nature of any adverse event., Severe effect related to treatment safety is defined as an adverse event occurring within the first cycle, judged to be related to treatment and meeting any of the following criteria: 1) Grade 3 non- hematological toxicity lasting more than 7 days 2) Grade 4 non- hematological toxicity., DLT as any grade 4 non-infective and non-hematologic adverse event that for the experience of the investigator cannot be due to FLAI chemotherapy alone and any grade 5 adverse event, Incidence, severity, seriousness and treatment-causality of Treatment Emergent Signs and Symptoms., Frequency of clinically significant abnormalities in physical examination, safety laboratory tests, vital signs and 12-Lead ECG, TLS occurred during or after protocol or transplant procedures for up to 1 years., Description of patient-reported QoL over time

Source: https://euclinicaltrials.eu/ctis-public/view/2023-510517-26-00